EU clinical trial 2024-518104-47-00: A clinical study of MK-2420 in healthy men (MK-2420-003)
Protocol code: MK-2420-003
Sponsor: Merck Sharp & Dohme LLC (Pharmaceutical company). Phase: Human Pharmacology (Phase I)- Other. Countries: Belgium (ended).
Therapeutic area(s): Diseases [C] - Immune System Diseases [C20]
Gender: Male. Age: 18-64 years. Enrolment: 48.
Status: Ended. Start date (EU): 2024-12-19. End date (EU): 2025-04-17. End date: 2025-04-18. Decision date: 2024-11-29. Results received: No. Last updated: 2024-11-29.

Condition(s): Rheumatoid arthritis

Source: https://euclinicaltrials.eu/ctis-public/view/2024-518104-47-00